EU clinical trial 2024-514163-26-00: A Phase II, Open-Label, Multicenter, Non-Randomized Study Of The Efficacy And Safety Of Enfortumab Vedotin In Combination With Pembrolizumab Previously Treated Advanced Melanoma
Protocol code: GEM 2303
Sponsor: Grupo Espanol Multidisciplinar De Melanoma (Patient organisation/association). Phase: Therapeutic exploratory (Phase II). Countries: Spain (ongoing, recruitment ended).
Therapeutic area(s): Diseases [C] - Neoplasms [C04]
Gender: Female, Male. Age: 18-64 years, 65+ years. Enrolment: 60.
Status: Ongoing, recruitment ended. Start date (EU): 2025-06-09. Decision date: 2025-03-18. Results received: No. Last updated: 2026-07-15.

Condition(s): Advanced Melanoma
Product: Padcev 30 mg powder for concentrate for solution for infusion, Padcev 20 mg powder for concentrate for solution for infusion, KEYTRUDA 25 mg/mL concentrate for solution for infusion

Primary endpoint: Objective Response Rate (ORR) as assessed by the investigator through Response Evaluation Criteria in Solid Tumors Version 1.1 (RECIST 1.1)(Appendix 4). This will be considered as the percentage/proportion of patients with confirmed complete response (CR) or partial response (PR) as their overall best response throughout the study.
Endpoint(s): Progression-free Survival (PFS) as assessed by RECIST 1.1. PFS is defined as the time from first dose of study treatment to the date of the first documentation of progressive disease (PD) or death from any cause, whichever occurs first., Overall Survival (OS), defined as the time from first dose of study treatment to the date of death from any cause., Clinical Benefit Rate (CBR), defined as proportion of patients with complete response (CR) or partial response (PR), according to ORR definition for the trial, or maintained stable disease (SD) as their overall best response, assessed by imaging follow-up (CT scan/MRI) and RECIST V1.1 criteria. Stable disease should be maintained for at least 4 months to be considered as a CBR event., Duration of Response (DoR) as Assessed by RECIST 1.1. DoR is considered an acceptable measure of clinical benefit when considered with ORR., Treatment-free Survival (TFS), defined as the time from the end of study treatment until the start of subsequent treatment, progression or death, whichever occurs first., Treatment-free Interval (TFI), defined as the time from the end study treatment until the start of subsequent treatment., The safety objective for this study is to evaluate the safety of EV plus pembrolizumab on the basis of the following endpoints: o Number of Participants with Adverse Events (AEs) Safety Objective o Incidence and severity of adverse events, with severity determined according to National Cancer Institute Common Terminology Criteria for Adverse Events, Version 5.0 (NCI CTCAE v5.0) o Number of Participants Who Discontinue Study Treatment Due to Adverse Events (AEs), Mean change from baseline in health-related quality of life (HRQoL) scores as assessed through use of the two-item global health status (GHS)/HRQoL subscale of the European Organisation for Research and Treatment of Cancer Quality ofLifeCore 30 (EORTC QLQ-C30) at specified time points.

Source: https://euclinicaltrials.eu/ctis-public/view/2024-514163-26-00